EU clinical trial 2024-512255-20-00: Clinical development and proof of principle testing of new regenerative VEGF-D therapy for cost-effective treatment of refractory angina. A phase II randomized, double-blinded, placebo-controlled study.
Protocol code: RGH201
Sponsor: Pohjois-Savon hyvinvointialue (Patient organisation/association). Phase: Therapeutic exploratory (Phase II). Countries: Denmark (ended), Finland (ended).
Therapeutic area(s): Diseases [C] - Cardiovascular Diseases [C14]
Gender: Female, Male. Age: 18-64 years, 65+ years. Enrolment: 39.
Status: Ended. End date (EU): 2024-05-31. Decision date: 2024-05-29. Results received: No. Last updated: 2024-05-31.
Decision dates by country: DK: 2024-05-31, FI: 2024-05-29

Condition(s): Clinical development and proof of principle testing of new regenerative VEGF-D therapy for cost- effective treatment of refractory angina. A phase II randomized, double-blinded, placebo-controlled study.
Product: AdsVEGF-D Delta N Delta C, Placebo to AdsVEGF-D Delta N Delta C test product

Primary endpoint: Improvement of functional capacity using 6-minute walking test, Improvement of symptoms assessed by Canadian Cardiovascular Society (CCS) class
Endpoint(s): Improvement of functional capacity using 6-minute walking test, Improvement of symptoms assessed by Canadian Cardiovascular Society (CCS) class, Increase in myocardial perfusion

Source: https://euclinicaltrials.eu/ctis-public/view/2024-512255-20-00